EU clinical trial 2022-502909-15-00: A Phase 2 Trial of Nivolumab Plus Ipilimumab, Ipilimumab Alone, or Cabazitaxel in Men with Metastatic Castration-Resistant Prostate Cancer
Protocol code: CA209650
Sponsor: Bristol Myers Squibb International Corporation (Pharmaceutical company). Phase: Therapeutic exploratory (Phase II). Countries: Germany (ended).
Therapeutic area(s): Diseases [C] - Neoplasms [C04]
Gender: Male. Age: 18-64 years, 65+ years. Enrolment: 69.
Status: Ended. Start date (EU): 2017-06-09. End date (EU): 2025-01-07. End date: 2025-01-08. Decision date: 2023-08-10. Results received: Yes. Last updated: 2024-11-22.

Condition(s): Metastatic Castration-Resistant Prostate Cancer
Product: OPDIVO 10 mg/mL concentrate for solution for infusion., OPDIVO 10 mg/mL concentrate for solution for infusion., MDX1106 ONO-4538, Ipilimumab, PREDNISONE, Ipilimumab, JEVTANA 60 mg concentrate and solvent for solution for infusion

Primary endpoint: Objective Response Rate (ORR) in Cohort B, C, and Cohort D, Radiographic Progression-Free Survival (rPFS)
Endpoint(s): Radiographic/Clinical Progression-Free Survival (rcPFS) in Cohort B, C, Radiographic/Clinical Progression-Free Survival (rcPFS) in Cohort D, Overall Survival (OS) in Cohort B, C, Overall Survival (OS) in Cohort D, Incidence of Adverse Events (AEs), Incidence of Serious Adverse Events (SAEs), Incidence of Adverse Events (AEs) leading to discontinuation, Incidence of Immune-mediated Adverse Events (IMAEs), Incidence of deaths, Incidence of laboratory abnormalities: Hematology, Clinical Chemistry, Coagulation, Liver function, Thyroid function, Adrenal function, Renal function, Number of participants with changes in pain as measured by Brief Pain Inventory-Short Form (BPI-SF), Estimated changes in health status and health utility as measured by the 3-level EuroQol Five Dimensions (EQ-5D-3L), Changes in cancer related symptoms and quality of life using the Functional Assessment Of Cancer Therapy - Prostate (FACT-P) questionnaire, Prostate Specfic Antigen (PSA) Response Rate

Source: https://euclinicaltrials.eu/ctis-public/view/2022-502909-15-00